EU clinical trial 2023-509500-15-00: REGOMUNE : A phase I/II study of Regorafenib plus Avelumab in solid tumors
Protocol code: IB 2017-01
Sponsor: Institut Bergonie (Hospital/Clinic/Other health care facility). Phase: Phase I and Phase II (Integrated)- Other. Countries: France (ongoing, recruitment ended).
Therapeutic area(s): Diseases [C] - Neoplasms [C04]
Gender: Female, Male. Age: 18-64 years, 65+ years. Enrolment: 827.
Status: Ongoing, recruitment ended. Start date (EU): 2018-05-03. Decision date: 2024-11-08. Results received: No. Last updated: 2026-07-20.

Condition(s): Adult patients with advanced or metastatic solid tumors
Product: AVELUMAB, BAY 73-4506

Primary endpoint: Phase I : Toxicity graded using the common toxicity criteria from the NC-CTCAE v5., Phase I : Incidence rate of DLT at each dose level during the first 28 days., Phase II-Cohorts A,C,D,E,F,G: Antitumor activity will be assessed in terms of objective response under treatment based on adapted RECIST 1.1 criteria, and after centralized radiological review:, 3a) Objective response under treatment is defined as patients with confirmed complete response (CR) or partial response, as per RECIST v1.1 criteria, observed during treatment with the investigational product(s)., 3b) As per RECIST v1.1 criteria, to be considered as “confirmed”, complete and partial responses will have to be confirmed at least 4 weeks later to ensure responses identified are not the result of measurement errors. If the new imaging to confirm response is not performed after 4 weeks, complete or partial responses will be considered as unconfirmed responses., 3c) Objective response rate (ORR) under treatment is defined as the proportion of patients with objective response (confirmed or unconfirmed) under treatment based on adapted RECIST 1.1., Phase II-Cohorts B,H,I,M,N,O,P,R: antitumor activity will be assessed in terms of 6-month progression-free rate (6- month PFR) based on RECIST 1.1 criteria after centralized radiological review. 6-month PFR is defined as the proportion of patients with progression-free status at 6 months. Progression-free status is defined as complete response (confirmed or unconfirmed), partial response (confirmed or unconfirmed) or stable disease more than 24 weeks as defined as per RECIST v1.1 criteria., Phase II-Cohort A': antitumor activity will be assessed in terms of 4- month progression-free rate (4-month PFR) based on RECIST 1.1 criteria after centralized radiological review. 4-month PFR is defined as the proportion of patients with progression-free status at 4 months. Progression-free status is defined as complete response (confirmed or unconfirmed), partial response (confirmed or unconfirmed) or stable disease more than 24 weeks as defined as per RECIST v1.1 criteria., Phase II-Cohorts J,K,L:antitumor activity will be assessed in terms of disease control rate at 6-month based on RECIST 1.1 criteria after centralized radiological review. 6-month DCR rate is defined as the proportion of participants with confirmed complete response, unconfirmed complete response, confirmed partial response or unconfirmed partial response within 24 weeks of treatment onset (while treated with the investigational product), or stable disease at 6 months, as per adapted RECIST v1.1., Phase II-Cohort Q: antitumor activity will be assessed in terms of 6-month radiographic progression-free rate (6-month rPFR) after centralized radiological review, as per RECIST 1.1 for extra-skeletal lesions and PCWG3 for skeletal lesions criteria response criteria [88]. 6-month rPFR is defined as the proportion of patients with radiographic progression-free status at 6 months. Radiographic progression is defined as per RECIST/PCWG3 criteria as soft-tissue and/or bone progression as follows :, 10a) Soft tissue: Radiographic progression is defined as an increase in measurable disease according to Response Evaluation Criteria in Solid Tumors (RECIST v1.1)., 10b) Bone: Bone progression is defined by the occurrence of at least 2 new lesions.
Endpoint(s): Phase I secondary endpoints : Preliminary signs of antitumor activity in terms of:, 1a) Best overall response defined as the best response recorded from the start of the study treatment until the end of treatment taking into account any requirement for confirmation as per RECIST v1.1 criteria., 1b) Objective response rate (ORR) defined as the proportion of patients with complete response or partial response, as per RECIST 1. ORR under treatment and 6-month ORR will be reported., 1c) Progression-free rate (PFR) at 6 months defined as the proportion of patients with complete response, partial response or stable disease more than 24 weeks as per RECIST v1.1 criteria., 1d) Progression-free survival (PFS) defined as the time from study treatment initiation to the first occurrence of disease progression or death (of any cause), whichever occurs first. 1-year PFS rate and median PFS will be reported., 1e) Overall Survival (OS) defined as the time from study treatment initiation to death (of any cause). 1-year OS rate and median OS will be reported., 1f) Growth modulation index (GMI): GMI will be defined for each patient as the ratio of its PFS on Regorafenib + Avelumab treatment to its PFS on the previous line of therapy. This method accounts for inter-patient variability, the patient serving as his/her own control and implies by the natural history of the disease that the PFS tends to become shorter in successive lines of therapy. It is thought that an anti-cancer agent should be considered effective if the GMI is greater than 1.3., Phase I secondary endpoints :PK measurements expressed as AUC, half-life and concentration peak for Regorafenib, Phase I secondary endpoints : Pharmacodynamic activity: Predictive biomarkers analysis and pharmacodynamic (PD)/mechanism of action (MOA) in blood (levels of angiogenic and immunologic biomarkers in blood at baseline and different study time points), potentially including but not limited to:, 9a) Serum/plasma cytokines levels (ELISA), 9b) Treg, CD4+, CD8+ and DR lymphocytes subpopulations (flow cytometry), 9c) Archived tumor tissue will be collected for assessment of tumor VEGFR, PDGFR, HIF1alpha expression and lymphocytes, TAM and MDSC tumor infiltrates (IHC), 9d) In additional, for all patients, optional biopsy at baseline and after 4 weeks of treatment will be proposed for mechanisms of action documentation: tumor VEGFR, PDGFR, HIF1alpha expression as well as PD-L1/PD1, lymphocytes, TAM, MDSC tumor infiltrates (IHC) and mutational burden., Phase II secondary endpoints [All cohorts, except cohort Q]: Best overall response is defined as the best response across all time points (RECIST v1.1). Following RECIST v1.1 recommendations:, 14a) The best overall response is determined once all the data for the patient is known., 14b) The best overall response will be classified as confirmed complete response (CR), unconfirmed complete response (CRu), confirmed partial response (PR), unconfirmed partial response (PRu), stable disease or progressive disease, as per RECIST v1.1 criteria., 14c) As per RECIST v1.1 criteria, to be considered as “confirmed”, complete and partial responses will have to be confirmed at least 4 weeks later to ensure responses identified are not the result of measurement errors., Phase II [All cohorts, except cohort Q]: Objective response rate at 6 months (6-month ORR) is defined as the proportion of patients with objective response (confirmed or unconfirmed) at 6 months., Phase II [All cohorts, except cohort Q]: Progression-free status is defined as complete response (confirmed or unconfirmed), partial response (confirmed or unconfirmed) or stable disease more than 24 weeks as defined as per RECIST v1.1 criteria (appendix 3). 6-month progression-free rate (6-month PFR) is defined as the proportion of patients with progression-free status at 6 months. 4- month progression-free rate is defined as the proportion of patients with progression-free status at 4 months., Phase II Cohort Q : PSA response rate is defined as the percentage of patients reaching a PSA decline from baseline ≥ 50% with PSA confirmation ≥ 3 weeks after the first documented reduction in PSA of ≥ 50%. The PSA response rate will be calculated as the proportion of participants with a PSA response in the PSA response-evaluable population., Phase II Cohort Q : The 1-year PSA response rate will be calculated as the proportion of participants with a PSA response at one year. after the first documented reduction in PSA, Phase II Cohort Q : PSA-Progression Free Survival (PSA-PFS) is defined as the time from treatment initiation until first evidence of PSA progression or until death from any cause, whichever comes first. PSA progression is defined by the criteria of the Prostate Cancer Clinical Trials Working Group (PCWG 3) as follows:, 22a) For patients with a PSA decrease observed after baseline: PSA progression is defined as the first PSA increase that is ≥ 25% and ≥ 2 ng/mL above the nadir, and which is confirmed by a second value ≥ 1 week later (i.e., a confirmed rising trend). The date of progression corresponds to the date of the first PSA increase that is ≥ 25% and ≥ 2 ng/mL above the nadir., 22b) For patients without a PSA decrease observed after baseline: PSA progression is defined as PSA progression ≥ 25% increase and ≥ 2 ng/mL increase from baseline beyond 12 weeks., Phase II : Growth modulation index (GMI): GMI is defined for each patient as the ratio of its PFS on Regorafenib + Avelumab treatment to its PFS on the previous line of therapy. This method accounts for inter-patient variability, the patient serving as his/her own control and implies by the natural history of the disease that the PFS tends to become shorter in successive lines of therapy. It is thought that an anticancer agent should be considered effective if the GMI is greater than 1.3., Phase II : Progression-free survival (PFS) is defined as the time from study treatment initiation to the first occurrence of disease progression or death (of any cause), whichever occurs first. 1-year PFS rate and median PFS will be reported., Phase II : Overall Survival (OS) is defined as the time from study treatment initiation to death (of any cause). 1-year OS rate and median OS will be reported., Phase II : Safety profile of the association Regorafenib + Avelumab: Toxicity will be graded using the common toxicity criteria from the NCI v5.0., Phase II : Pharmacodynamic activity: o archived tumor tissue will be collected for assessment of the tumor microenvironment. o to perform integrative assessment of biomarkers of efficacy (genetic, metabolomics profiling in blood/tissue at baseline and different study time points) and its prognostic value on efficacy., Phase II Cohort B : To evaluate the antitumor activity based on Choi criteria in terms of non-progression at 6 months.

Source: https://euclinicaltrials.eu/ctis-public/view/2023-509500-15-00